EU clinical trial 2022-502773-41-00: A Phase I/II Open-label, Multi-center Study to Assess Safety, Tolerability, Pharmacokinetics and Preliminary Efficacy of AZD7789, an anti-PD-1 and anti-TIM-3 Bispecific Antibody, in Patients with Relapsed or Refractory Classical Hodgkin Lymphoma
Protocol code: D9571C00001
Sponsor: AstraZeneca AB (Pharmaceutical company). Phase: Phase I and Phase II (Integrated)- Other. Countries: Italy (ended), Denmark (ended), Spain (ended), France (ended).
Therapeutic area(s): Diseases [C] - Hemic and Lymphatic Diseases [C15]
Gender: Female, Male. Age: 0-17 years, 18-64 years, 65+ years. Enrolment: 78.
Status: Ended. Start date (EU): 2022-06-16. End date (EU): 2025-09-04. End date: 2025-09-05. Decision date: 2024-02-28. Results received: Yes. Last updated: 2024-09-20.
Decision dates by country: ES: 2024-02-29, FR: 2024-03-11, DK: 2024-02-28, IT: 2024-03-11

Condition(s): Relapsed/Refractory Classical Hodgkin Lymphoma
Product: PARACETAMOL, DIPHENHYDRAMINE, INFLIXIMAB, TOCILIZUMAB, AZD7789, EPINEPHRINE

Primary endpoint: Part A Dose Escalation: Incidence of AEs, imAEs, and SAEs Incidence of AEs leading to discontinuation of sabestomig Changes from baseline and clinically significant alterations in vital signs, laboratory parameters, and ECG results Incidence of dose-limiting toxicities, Part B Dose Expansion (all): Incidence of AEs, imAEs, and SAEs Incidence of AEs leading to discontinuation of sabestomig Changes from baseline and clinically significant alterations in vital signs, laboratory parameters, and ECG results, Part B Dose Expansion (B1): Objective Response Rate (defined as the proportion of patients with complete remission or partial remission), Part B Dose Expansion (B2): Complete Response Rate (defined as the proportion of patients with complete remission)
Endpoint(s): Part A Dose Escalation: Complete Response Rate, Objective Response Rate, DoR, and DoCR and PFS including landmarks at 12 and 24 months OS including landmarks at 12 and 24 months, Part B Dose Expansion: DoR, DoCR and PFS including landmarks at 12 and 24 months OS including landmarks at 12 and 24 months Proportion of dosed subjects over time with: diarrhea, rash, and fatigue (PRO-CTCAE or Peds-PROCTCAE) overall side-effect bother (PGI-TT) quality of life/health (EORTC ILXX QL2), Part A Dose Escalation and Part B Dose Expansion: PK parameters including the maximum observed concentration, area under the concentration-time curve, clearance and terminal elimination half life • Incidence of anti-drug antibodies against sabestomig in serum

Source: https://euclinicaltrials.eu/ctis-public/view/2022-502773-41-00